EU clinical trial 2024-511316-25-00: A Phase Ib/II, Open-Label, Multicenter, Randomized Umbrella Study Evaluating the Efficacy and Safety of Multiple Immunotherapy-Based Treatments and Combinations in Patients with Urothelial Carcinoma (MORPHEUS-UC)
Protocol code: WO39613
Sponsor: F. Hoffmann-La Roche AG (Pharmaceutical company). Phase: Human Pharmacology (Phase I)- Other. Countries: France (ended), Greece (ended), Spain (ended).
Therapeutic area(s): Diseases [C] - Neoplasms [C04]
Gender: Female, Male. Age: 18-64 years, 65+ years. Enrolment: 220.
Status: Ended. Start date (EU): 2019-06-04. End date (EU): 2025-11-12. End date: 2025-12-22. Decision date: 2024-07-05. Results received: Yes. Last updated: 2026-01-20.
Decision dates by country: FR: 2024-07-23, GR: 2024-09-25, ES: 2024-07-05

Condition(s): Urothelial carcinoma (UC)
Product: Tiragolumab, CISPLATIN, Tecentriq 1 200 mg concentrate for solution for infusion, GEMCITABINE

Primary endpoint: 1. Objective response rate (mUC Cohort), 2. Pathological complete response (MIBC Cohorts)
Endpoint(s): 1. Progression-free survival, 2. Overall survival after randomization, 3. Overall survival rate at specific time points, 4. Duration of response, 5. Disease control, 6. Incidence, nature, and severity of adverse events and laboratory abnormalities, with severity determined according to National Cancer Institute Common Terminology Criteria for Adverse Events, Version 4.0, 7. Change from baseline in vital signs, 8. Change from baseline in targeted clinical laboratory test results MIBC Cohorts, 9. Landmark recurrence-free survival, event-free survival and overall survival MIBC Cohorts, 10. Incidence, nature, and severity of adverse events and laboratory abnormalities, with severity determined according to NCI CTCAE v4.0

Source: https://euclinicaltrials.eu/ctis-public/view/2024-511316-25-00